EU clinical trial 2022-502640-12-01: DART (19-14434) Durvalumab (MEDI4736) After chemoRadioTherapy (DART) for NSCLC patients – a phase II translational and biomarker study investigating PDL1 positive and negative patients
Protocol code: ESR-19-14434
Sponsor: Oslo University Hospital Hf (Hospital/Clinic/Other health care facility). Phase: Phase I and Phase II (Integrated)- Other. Countries: Estonia (ongoing, recruitment ended), Norway (ongoing, recruitment ended), Finland (ongoing, recruitment ended), Lithuania (ongoing, recruitment ended).
Therapeutic area(s): Diseases [C] - Neoplasms [C04]
Gender: Female, Male. Age: 18-64 years, 65+ years. Enrolment: 130.
Status: Ongoing, recruitment ended. Start date (EU): 2024-09-27. Decision date: 2024-09-27. Results received: No. Last updated: 2024-10-23.
Decision dates by country: EE: 2024-09-27, LT: 2024-10-23, FI: 2024-09-27, NO: 2024-09-27

Condition(s): Non-small cell lung cancer (NSCLC)

Source: https://euclinicaltrials.eu/ctis-public/view/2022-502640-12-01